EU clinical trial 2022-502030-12-01: This is a first in human study, in patients with severe bleeding disorder (hemophilia A), who has developed inhibitory antibodies against coagulation factor VIII.The aim is to study the safety and efficacy of dendritic cells, originating from the patient itself. The dendritic cells has been loaded with coagulation factor VIII for an improved immunological tolerance. (TOLER8)
Protocol code: 21-ItolDC-028-01
Sponsor: Cell4Cure AB (Pharmaceutical company). Phase: Human Pharmacology (Phase I)- First administration to humans. Countries: Sweden (authorised, recruitment pending), Norway (authorised, recruiting).
Therapeutic area(s): Phenomena and Processes [G] - Immune system processes [G12]
Gender: Male. Age: 18-64 years. Enrolment: 4.
Start date (EU): 2022-10-13. Decision date: 2022-12-05. Results received: No. Last updated: 2025-03-24.
Decision dates by country: SE: 2022-12-05, NO: 2022-12-13

Condition(s): Treatment of patients with Hemophilia A who have developed inhibitory antibodies to clotting Factor VIII and have failed Immune Tolerance Induction

Source: https://euclinicaltrials.eu/ctis-public/view/2022-502030-12-01